EU clinical trial 2023-506139-13-00: A PHASE 1/3 STUDY TO EVALUATE THE EFFICACY AND SAFETY OF SELINEXOR, A SELECTIVE INHIBITOR OF NUCLEAR EXPORT, IN COMBINATION WITH RUXOLITINIB IN TREATMENT-NAÏVE PATIENTS WITH MYELOFIBROSIS
Protocol code: XPORT-MF-034
Sponsor: Karyopharm Therapeutics Inc. (Pharmaceutical company). Phase: Therapeutic confirmatory (Phase III). Countries: France (ongoing, recruitment ended), Spain (ongoing, recruitment ended), Czechia (ongoing, recruitment ended), Italy (ongoing, recruitment ended), Bulgaria (ongoing, recruitment ended), Romania (ongoing, recruitment ended), Hungary (ongoing, recruitment ended), Netherlands (ongoing, recruitment ended), Denmark (ongoing, recruitment ended), Poland (ongoing, recruitment ended), Belgium (ongoing, recruitment ended), Germany (ongoing, recruitment ended), Greece (ongoing, recruitment ended).
Therapeutic area(s): Diseases [C] - Hemic and Lymphatic Diseases [C15]
Gender: Female, Male. Age: 18-64 years, 65+ years. Enrolment: 195.
Status: Ongoing, recruitment ended. Start date (EU): 2024-01-04. Decision date: 2023-11-27. Results received: No. Last updated: 2026-07-29.
Decision dates by country: HU: 2024-03-25, DK: 2024-02-28, RO: 2024-02-26, ES: 2023-11-27, NL: 2024-03-22, DE: 2024-01-31, GR: 2024-04-01, BE: 2024-03-25, PL: 2024-04-02, BG: 2024-03-28, CZ: 2024-03-28, FR: 2023-11-30, IT: 2024-02-06

Condition(s): Treatment naïve patients with MF
Product: NETUPITANT, ONDANSETRON ZYDUS 8 mg, comprimé orodispersible, SELINEXOR, Jakavi 20 mg tablets, Selinexor placebo for 20 mg tablets formulated for oral administration., EMEND 125 mg+80 mg hard capsules, PALONOSETRON, Jakavi 5 mg tablets, Jakavi 10 mg tablets, Akynzeo 300 mg/0.5 mg hard capsules, Jakavi 15 mg tablets, ONDANSETRON

Primary endpoint: Proportion of patients with spleen volume reduction (SVR) of ≥35% (SVR35) at Week 24 as measured by MRI or CT scan by Investigator assessment, Absolute mean change in TSS (Abs-TSS) from baseline to Week 24 as measured by the Myelofibrosis Symptom Assessment Form (MFSAF) v4.0a
Endpoint(s): Proportion of patients with SVR35 at Week 48 as measured by MRI or CT scan by Investigator assessment, Overall survival (OS) defined as the time interval from the date of randomization to the date of death due to any cause., PFS as defined in the statistical analysis plan (SAP), Proportion of patients with SVR35 at any time point in the study as measured by MRI or CT scan., Absolute mean change in TSS (Abs-TSS) from baseline to Week 48 as measured by the Myelofibrosis Symptom Assessment Form (MFSAF) v4.0a, Incidence and severity of TEAEs including treatment-related adverse events (TRAEs), SAEs., PK endpoints including but not limited to AUC, Cmax, and Tmax., Proportion of patients with at least a 1-grade decrease in bone marrow fibrosis at any point in the study., Progression-free survival (PFS)

Source: https://euclinicaltrials.eu/ctis-public/view/2023-506139-13-00